EU clinical trial 2024-516680-91-00: An Open Label Extension Study of Ublituximab in Subjects with Relapsing Multiple Sclerosis
Protocol code: TG1101-RMS303
Sponsor: Tg Therapeutics Inc. (Pharmaceutical company). Phase: Therapeutic confirmatory (Phase III). Countries: Poland (ongoing, recruitment ended), Croatia (ongoing, recruitment ended).
Therapeutic area(s): Diseases [C] - Nervous System Diseases [C10]
Gender: Female, Male. Age: 18-64 years. Enrolment: 137.
Status: Ongoing, recruitment ended. Start date (EU): 2020-05-21. Decision date: 2024-11-11. Results received: No. Last updated: 2026-07-16.
Decision dates by country: PL: 2024-11-11, HR: 2024-11-28

Condition(s): relapsing multiple sclerosis
Product: ublituximab

Primary endpoint: Relapses: • Annualized Relapse Rate (ARR) is defined as the number of relapses per- subject year. The estimate of ARR will be the total number of relapses divided by the sum of duration on study treatment (years)., MRI parameters: • T1 gadolinium enhancing (Gd-enhancing) • T1 hypointense lesions • T2 lesions • Brain atrophy, Disability: • 24-Week Confirmed Disability Progression (CDP) • 24-Week Confirmed Disability Improvement (CDI) • Mean change from baseline in EDSS score, No Evidence of Disease Activity (NEDA): • NEDA is defined as subjects without relapses, MRI activities (no T1 Gd-enhancing lesions and no new/enlarging T2 lesions), and no 24-week confirmed disability progression. • The percent of subjects with no evidence of disease activity, Cognition and Function: • Cognition will be measured by Symbol Digit Modalities Test (SDMT) • Function will be measured by Multiple Sclerosis Functional Composite (MSFC), Safety Endpoints: All AEs will be reported and evaluated during the treatment period using NCI CTCAE v.5.0 grading system; the number and severity of infusion-associated events; the number and severity of infectious AEs; any clinically significant changes in laboratory or vital sign measurements; the incidence of anti-drug antibodies

Source: https://euclinicaltrials.eu/ctis-public/view/2024-516680-91-00